EU clinical trial 2023-503738-36-00: A Multiple Ascending Dose Clinical Study to Evaluate the Safety, Tolerability, and Pharmacokinetics of MK-7602 in Healthy Participants
Protocol code: MK-7602-002
Sponsor: Merck Sharp & Dohme LLC (Pharmaceutical company). Phase: Human Pharmacology (Phase I)- Other. Countries: Belgium (ended).
Therapeutic area(s): Diseases [C] - Parasitic Diseases [C03]
Gender: Female, Male. Age: 18-64 years. Enrolment: 40.
Status: Ended. Start date (EU): 2023-05-12. End date (EU): 2023-11-09. End date: 2023-11-10. Decision date: 2023-05-02. Results received: Yes. Last updated: 2023-05-02.

Condition(s): Malaria
Product: Microcrystalline Cellulose, Lactose Monohydrate, Magnesium Stearate (non bovine), Microcrystalline cellulose, lactose monohydrate, magnesium stearate (non bovine)

Primary endpoint: Number of Participants Who Experience At least One Adverse Event (AE), Number of Participants who Discontinue Study Treatment Due to an AE, Area Under the Curve Time 0 to End of the Dosing Interval (AUC0-tau) of MK-7602, Maximum Plasma Concentration (Cmax) of MK-7602, Through Plasma Concentration (Ctrough) of MK-7602, Time of Maximum Plasma Concentration (Tmax) of MK-7602, Apparent Plasma Terminal Half-life (t1/2) of MK-7602, Apparent Total Clearance of MK-7602 from Plasma After Oral Administration (CL/F), Apparent Volume of Distribution During Terminal Phase (Vz/F) of MK-7602, Accumulation Ratio for AUC0-tau of MK-7602, Accumulation Ratio for Cmax of MK-7602

Source: https://euclinicaltrials.eu/ctis-public/view/2023-503738-36-00